EU clinical trial 2023-503974-19-00: Effect of Allogenic Ex-vivo Expanded Bone Marrow Derived Mesenchymal Stem Cells on Knee Osteoarthritis – A Randomized Controlled Trial
Sponsor: Odense University Hospital (Hospital/Clinic/Other health care facility). Phase: Phase II and Phase III (Integrated). Countries: Denmark (not authorised).
Therapeutic area(s): Diseases [C] - Musculoskeletal Diseases [C05]
Gender: Female, Male. Age: 18-64 years, 65+ years. Enrolment: 112.
Status: Not authorised. Decision date: 2025-07-14. Results received: No. Last updated: 2025-07-14.

Condition(s): Osteoarthritis in knee joint

Source: https://euclinicaltrials.eu/ctis-public/view/2023-503974-19-00